EU clinical trial 2025-520695-26-00: Comparison of the preventive painkiller effect of etoricoxib and celecoxib after M3M surgery: A randomized, double-masked clinical trial
Protocol code: COX2M3M
Sponsor: Semmelweis University (Educational Institution). Phase: Therapeutic use (Phase IV). Countries: Hungary (authorised, recruitment pending).
Therapeutic area(s): Diseases [C] - Stomatognathic Diseases [C07]
Gender: Female, Male. Age: 18-64 years. Enrolment: 75.
Status: Authorised, recruitment pending. Decision date: 2025-01-22. Results received: No. Last updated: 2025-01-22.

Condition(s): postoperative period after mandibular M3 removal
Product: ETORICOXIB, CELECOXIB

Primary endpoint: Based on literature data, it is anticipated that the patients in the etoricoxib group will experience a greater reduction in postoperative pain and discomfort compared to the control (placebo) group. This outcome is hypothesized based on the pharmacological properties of the drug.

Source: https://euclinicaltrials.eu/ctis-public/view/2025-520695-26-00